EU clinical trial 2024-514586-20-01: IFCT-1701 DICIPLE A randomized phase 3 trial comparing continuation Nivolumab-Ipilimumab doublet immunotherapy until progression versus observation in treatment-naive patients with stage IV Non-Small Cell Lung Cancer (NSCLC) after Nivolumab-Ipilimumab induction treatment
Protocol code: IFCT-1701
Sponsor: Intergroupe Francophone De Cancerologie Thoracique (Patient organisation/association). Phase: Therapeutic confirmatory (Phase III). Countries: France (ended).
Therapeutic area(s): Diseases [C] - Neoplasms [C04]
Gender: Female, Male. Age: 18-64 years, 65+ years. Enrolment: 1360.
Status: Ended. Start date (EU): 2018-05-02. End date (EU): 2025-10-15. Decision date: 2025-01-21. Results received: No. Last updated: 2025-09-11.

Condition(s): Non small cell lung cancer
Product: YERVOY 5 mg/ml concentrate for solution for infusion, OPDIVO 10 mg/mL concentrate for solution for infusion.

Primary endpoint: Progression Free Survival (PFS1)
Endpoint(s): Progression Free Survival (PFS2), Quality of life (QoL), Overall survival (OS), Biological correlative exploratory studies (PD-L1), Biological correlative exploratory studies (PD-L1 H score), Biological correlative exploratory studies (CD3/CD8), Biological correlative exploratory studies (neutrophil), Biological correlative exploratory studies (cytokines), Biological correlative exploratory studies (chemokines)

Source: https://euclinicaltrials.eu/ctis-public/view/2024-514586-20-01